EU clinical trial 2024-514592-17-00: A Prospective Phase II Clinical Trial Evaluating the Efficacy and the Safety of Tyrosine Kinase Inhibitors Withdrawal After a Previous Two-step Dose Reduction in Patients With Chronic Myeloid Leukemia in Deep Molecular Remission
Protocol code: HALF2019
Sponsor: Masarykova Univerzita (Educational Institution). Phase: Therapeutic exploratory (Phase II). Countries: Czechia (ended).
Therapeutic area(s): Diseases [C] - Hemic and Lymphatic Diseases [C15]
Gender: Female, Male. Age: 18-64 years, 65+ years. Enrolment: 221.
Status: Ended. Start date (EU): 2020-06-16. End date (EU): 2026-07-02. Decision date: 2024-09-12. Results received: No. Last updated: 2025-11-06.

Condition(s): chronic myeloid leukemia
Product: SPRYCEL 20 mg film-coated tablets, Tasigna 200 mg hard capsules, Glivec 100 mg hard capsules, Tasigna 150 mg hard capsules

Primary endpoint: Proportion of patients in major molecular response (MMR) ie BCR-ABL1 (oncogenic BCR-ABL gene fusion transcript levels <= 0.1%) and Molecular Recurrence-Free Survival (MRFS, ie time from study entry to MMR loss, ie BCR-ABL1 transcript levels > 0.1% in 2 consecutive samples, or death from any cause) at month 6 after study entry, Proportion of patients in major molecular response (MMR) and MRFS at month 12 after study entry, Proportion of patients in MMR without treatment (TFR) and treatment-free survival (TFS, ie the time from withdrawal of TKI (tyrosin kinase inhibitors) to loss of MMR, reinitiation of TKI therapy from any cause, progression, or death from any cause) at month 18, 24 and 36 after study entry, ie, 6, 12 and 24 months after treatment discontinuation
Endpoint(s): Proportion of patients who lose MMR during de-escalation and in whom MMR and MR4.0 will recover after TKI re-introduction, Proportion of patients who lose MMR after discontinuation of TKI and in whom MMR and MR4.0 will recover after TKI re-introduction, Time to re-establish MMR and MR4.0 after TKI restart, Assessment of TKI's adverse effects dynamics during two-step reduction of their dose before withdrawal, Assessment of TKI withdrawal syndrome (proportion of patients with development of withdrawal syndrome, severity of symptoms, time to first complaint, duration of complaints, therapeutic intervention), Assessment of the correlation between adverse effects on previous TKI treatment and possible withdrawal syndrome, Correlation of BCR-ABL1 kinetics (number of BCR-ABL1 transcripts in time) during TKI therapy with potential molecular relapse after TKI discontinuation, Correlation of the effect of TKI dose reduction and subsequent discontinuation with lipid metabolism and glycemia

Source: https://euclinicaltrials.eu/ctis-public/view/2024-514592-17-00